EU clinical trial 2025-522967-13-00: A multicenter randomized, controlled, single-blind, adaptive phase IV clinical trial to evaluate the efficiency and effectiveness of a pre-emptive pharmacogenetic strategy for antidepressant selection in patients with depressive disorder: The PREDICT adaptive clinical trial.
Protocol code: PREDICT
Sponsor: Fundacion Para La Investigacion Biomedica Del Hospital Universitario La Paz (Patient organisation/association). Phase: Therapeutic use (Phase IV). Countries: Spain (authorised, recruitment pending).
Therapeutic area(s): Psychiatry and Psychology [F] - Mental Disorders [F03]
Gender: Female, Male. Age: 18-64 years, 65+ years. Enrolment: 240.
Status: Authorised, recruitment pending. Decision date: 2026-01-11. Results received: No. Last updated: 2026-07-28.

Condition(s): Depressive disorder
Product: mirtazapina cinfa 30 mg comprimidos recubiertos con película EFG, Bupropión Sandoz 150 mg comprimidos de liberación modificada EFG., Quetiapina NORMON 300 mg comprimidos recubiertos con película EFG, Amitriptyline hydrochloride 25 mg film-coated tablets, Venlafaxina Retard Sandoz 75 mg cápsulas duras de liberación prolongada EFG, Lantanon 10 mg comprimidos recubiertos con película, Anafranil 10 mg comprimidos recubiertos, Fluoxetina Viatris 20 mg cápsulas duras EFG, Fluvoxamina Sandoz 50 mg comprimidos recubiertos con pelicula EFG, NORFENAZIN “25”®, Valdoxan 25 mg film-coated tablets, Citalopram Normon 20 mg comprimidos recubiertos con película EFG, PAROXETINA 20 mg comprimidos recubiertos con película EFG, Sertralina cinfa 150 mg comprimidos recubiertos con película, Desvenlafaxina cinfa 50 mg comprimidos de liberación prolongada EFG, Duloxetina Eignapharma 30 mg cápsulas duras gastrorresistentes EFG, Vortioxetina Kern Pharma 5 mg comprimidos recubiertos con película EFG, escitalopram cinfa 10 mg comprimidos recubiertos con película EFG, TOFRANIL 10 mg comprimidos recubiertos, Surmontil 25 mg comprimidos recubiertos con película

Primary endpoint: Symptom remission, based on changes in depression severity scores (PHQ-9 and MADRS), after initiation of a new antidepressant treatment following failure of the prior therapy at study entry.
Endpoint(s): Total number of therapeutic adjustments performed within 16 weeks after initiation of a new antidepressant treatment following failure of the prior therapy at study entry. “Therapeutic adjustment” includes: • Change of antidepressant (switch) • Dose increase or decrease (beyond standard titration), Total number and type of Psychotherapeutic appointments—such as cognitive behavioral therapy (CBT) and interpersonal therapy (IPT) per arm. • Total number of hospitalizations per arm. • Total number of clinical visits (scheduled and unscheduled). • Total number of non-scheduled psychiatric consultations in each arm., Incremental cost-effectiveness ratios (ICERs), comparing cost differences relative to differences in clinical efficacy between the two arms., Total number of adverse events (AEs) in each cohort., Total number of hospitalizations per arm., Total number of clinical visits (scheduled and unscheduled)., Total number of non-scheduled psychiatric consultations in each arm., Total number of participants with symptom remission remains at the end of the 16-week follow-up period., Total costs in the intervention arm (including pharmacogenetic testing and clinical event costs) versus total costs related to clinical events in the control arm., Incremental cost of pharmacogenetic testing and associated implementation procedures., Total number of serious adverse events (SAEs) in each cohort., Total number of dropouts due to SAEs., Incidence of adverse events of special interest: Suicidal ideation, Suicide attempt, Serotonin syndrome, and Neuroleptic malignant syndrome.

Source: https://euclinicaltrials.eu/ctis-public/view/2025-522967-13-00